EU clinical trial 2024-517481-41-00: Study of the impact of DPD activity on the efficacy of capecitabine
Protocol code: DPD MAX
Sponsor: Centre Antoine Lacassagne (Hospital/Clinic/Other health care facility). Phase: Phase I and Phase II (Integrated)- Other. Countries: France (ongoing, recruitment ended).
Therapeutic area(s): Diseases [C] - Neoplasms [C04]
Gender: Female, Male. Age: 18-64 years, 65+ years. Enrolment: 155.
Status: Ongoing, recruitment ended. Start date (EU): 2024-10-02. Decision date: 2024-10-02. Results received: No. Last updated: 2026-04-23.

Condition(s): breast cancer

Source: https://euclinicaltrials.eu/ctis-public/view/2024-517481-41-00